EU clinical trial 2024-515174-27-00: DK-CLIC-1901 CAR T-cells for treatment of patients with relapsed/refractory CD19 positive hematological malignancies (DAN-CART 1901)
Protocol code: RHCART1A
Sponsor: Rigshospitalet (Hospital/Clinic/Other health care facility). Phase: Therapeutic exploratory (Phase II). Countries: Denmark (ongoing, recruiting).
Therapeutic area(s): Diseases [C] - Hemic and Lymphatic Diseases [C15]; Diseases [C] - Neoplasms [C04]
Gender: Female, Male. Age: 0-17 years, 18-64 years, 65+ years. Enrolment: 15.
Status: Ongoing, recruiting. Start date (EU): 2022-10-03. Decision date: 2024-08-13. Results received: No. Last updated: 2025-08-29.

Condition(s): Acute Lymphoblastic Leukemia and B-cell Non Hodgkin Lymphoma
Product: RoActemra 20 mg/mL concentrate for solution for infusion, RoActemra 20 mg/mL concentrate for solution for infusion, DK-CLIC-1901

Primary endpoint: CRS: registration according to international grading system[31]. Endpoints include proportion of patients experiencing CRS of all grades and CRS grade 3-4, ICANS: registration according to international grading system[31]. Endpoints include proportion of patients experiencing ICANS of all grades and ICANS grade 3-4., Treatment with tocilizumab and/or glucocorticoids for CRS/ICANS., Cytopenia, including ICAHT grade ≥3 at day +28 and time to reach acceptable levels of neutrophils (≥1,.0 in three consecutive days), thrombocytes (≥100 in three consecutive days) and hemoglobin after CAR T-cell infusion., Episodes of neutropenic fever (temperature >38.5 °C and neutrophils <0.5), Admission at the intensive care unit (ICU) or pediatric intensive care unit (PICU), Death from any cause
Endpoint(s): Response rates defined as complete response, partial response, stable response or progressive disease, Overall survival (OS), progression-free survival (PFS), non-relapse mortality (NRM) and treatment with allogeneic hematopoietic stem cell transplantation (HSCT)

Source: https://euclinicaltrials.eu/ctis-public/view/2024-515174-27-00